EU clinical trial 2024-517727-39-00: C5091017 - AN INTERVENTIONAL EFFICACY AND SAFETY, PHASE 3, DOUBLE-BLIND, 2 ARM STUDY TO INVESTIGATE ORALLY ADMINISTERED IBUZATRELVIR COMPARED WITH PLACEBO IN NON-HOSPITALIZED SYMPTOMATIC ADULT AND ADOLESCENT PARTICIPANTS WITH COVID-19 WHO ARE AT HIGH RISK OF PROGRESSING TO SEVERE ILLNESS
Protocol code: C5091017
Sponsor: Pfizer Inc. (Pharmaceutical company). Phase: Therapeutic confirmatory (Phase III). Countries: Finland (ongoing, recruiting), Germany (ongoing, recruiting), Belgium (ongoing, recruiting), Bulgaria (ongoing, recruiting), Slovakia (ongoing, recruiting), Denmark (authorised, recruiting), Spain (ongoing, recruiting), Czechia (ongoing, recruiting).
Therapeutic area(s): Diseases [C] - Virus Diseases [C02]
Gender: Female, Male. Age: 0-17 years, 18-64 years, 65+ years. Enrolment: 541.
Start date (EU): 2025-07-28. Decision date: 2025-06-03. Results received: No. Last updated: 2026-05-14.
Decision dates by country: BG: 2025-06-06, ES: 2025-07-15, SK: 2025-06-04, BE: 2025-06-04, DE: 2025-06-04, DK: 2025-06-03, FI: 2025-06-05, CZ: 2025-09-15

Condition(s): Covid-19 at high risk of progression to severe illness.
Product: Placebo to Ibuzatrelvir film-coated tablet, PF-07817883 Tablet

Primary endpoint: Proportion of participants with COVID-19-related emergency department visits with administration of supplemental oxygen, COVID-19 antiviral or IV treatment (eg, hydration, antibiotics, or corticosteroids), all-cause hospitalization, or all-cause death through Day 28.
Endpoint(s): Time (days) to sustained resolution of all targeted COVID-19 symptoms through Day 28., Proportion of participants with CRPE from Day 1 to Week 24, Proportion of participants with PACE from Day 29 to Week 24, Proportion of participants with Long COVID/PASC symptoms at Week 24, based on the Long COVID/PASC PRO.

Source: https://euclinicaltrials.eu/ctis-public/view/2024-517727-39-00